EU clinical trial 2024-514216-27-00: A Phase 1 Study of BGB-B3227 Alone and in Combination With Tislelizumab in Patients With Advanced or Metastatic Solid Tumors
Protocol code: BGB-3227-101
Sponsor: BeOne Medicines AG (Pharmaceutical company). Phase: Human Pharmacology (Phase I)- First administration to humans. Countries: Italy (ended).
Therapeutic area(s): Diseases [C] - Neoplasms [C04]
Gender: Female, Male. Age: 18-64 years, 65+ years. Enrolment: 35.
Status: Ended. Start date (EU): 2025-01-17. End date (EU): 2025-12-23. End date: 2026-01-09. Decision date: 2024-12-11. Results received: No. Last updated: 2025-11-25.

Condition(s): Solid tumors

Source: https://euclinicaltrials.eu/ctis-public/view/2024-514216-27-00